EU clinical trial 2024-516782-36-00: An international multicentric randomized phase II evaluating dostarlimab in combination with niraparib versus niraparib alone compared to chemotherapy in the treatment of metastatic or recurrent endometrial or ovarian carcinosarcoma after at least one line of chemotherapy : ROCSAN study
Protocol code: GINECO-EN203b
Sponsor: Asso De Recherche Cancers Gynecologiques (Laboratory/Research/Testing facility). Phase: Therapeutic exploratory (Phase II). Countries: France (ongoing, recruiting), Italy (authorised, recruitment pending), Spain (ongoing, recruiting).
Therapeutic area(s): Diseases [C] - Neoplasms [C04]
Gender: Female. Age: 18-64 years, 65+ years. Enrolment: 135.
Start date (EU): 2024-10-15. Decision date: 2024-10-15. Results received: No. Last updated: 2026-07-29.
Decision dates by country: FR: 2024-10-15, IT: 2025-10-07, ES: 2025-09-08

Condition(s): metastatic or recurrent endometrial or ovarian carcinosarcoma
Product: Zejula 100 mg hard capsules, Zejula 100 mg film-coated tablets, JEMPERLI 500 mg concentrate for solution for infusion

Primary endpoint: Step 1 - Selection Phase : Response Rate at 4 months (W16-RR) as per RECIST 1.1, Step 2 – Extension phase :6-months Overall survival (OS) rate.
Endpoint(s): Progression-Free Survival (PFS), Time To Subsequent Treatment or Death, Progression-Free Survival 2 (PFS2), Overall Survival, Objective Response Rate (ORR), Disease Control Rate (DCR), Duration of response, Safety and Tolerability, QoL & symptom benefit evaluation

Source: https://euclinicaltrials.eu/ctis-public/view/2024-516782-36-00